EU clinical trial 2024-516239-28-00: Evaluation of the Efficacy of an Intra-articular Injection of Autologous Microfat Combined With Autologous Platelet-enriched Plasma in the Treatment of Radiocarpal Osteoarthritis: a Randomized Controlled Non-inferiority Trial Versus Total Wrist Denervation (Established Standard Treatment). AMIPREP 2
Sponsor: Centre Hospitalier Regional De Marseille (Hospital/Clinic/Other health care facility). Phase: Therapeutic exploratory (Phase II). Countries: France (ongoing, recruiting).
Therapeutic area(s): Diseases [C] - Musculoskeletal Diseases [C05]
Gender: Female, Male. Age: 18-64 years, 65+ years. Enrolment: 36.
Status: Ongoing, recruiting. Start date (EU): 2023-02-17. Decision date: 2024-09-06. Results received: No. Last updated: 2025-03-07.

Condition(s): Radiocarpal Osteoarthritis
Product: MICROFAT 2 mL AND PLATELET RICH PLASMA HUMAN 2 mL MIXTURE

Primary endpoint: Pain intensity measured on the visual analog scale (EVA) at 6 month after treatment

Source: https://euclinicaltrials.eu/ctis-public/view/2024-516239-28-00